EU clinical trial 2022-500508-23-00: Anti-CEACAM5 ADC M9140 in Advanced Solid Tumors
Protocol code: MS202329_0001
Sponsor: Merck Healthcare KGaA (Pharmaceutical company). Phase: Human Pharmacology (Phase I)- First administration to humans. Countries: Spain (ongoing, recruiting), Germany (ended).
Therapeutic area(s): Diseases [C] - Neoplasms [C04]
Gender: Female, Male. Age: 18-64 years, 65+ years. Enrolment: 116.
Start date (EU): 2022-10-28. Decision date: 2022-09-15. Results received: No. Last updated: 2025-09-09.
Decision dates by country: DE: 2024-08-02, ES: 2022-09-15

Condition(s): Advanced solid tumors

Source: https://euclinicaltrials.eu/ctis-public/view/2022-500508-23-00